EU clinical trial 2025-522253-19-00: A Phase 1/2 Open-Label Rolling-Arm Umbrella Platform Study of Investigational Agents in Combination With Enfortumab Vedotin Plus Pembrolizumab as First-Line Treatment in Participants With Locally Advanced or Metastatic Urothelial Carcinoma: KEYMAKER-U04–Substudy 04D
Protocol code: MK-3475-04D
Sponsor: Merck Sharp & Dohme LLC (Pharmaceutical company). Phase: Phase I and Phase II (Integrated)- Other. Countries: Netherlands (ongoing, recruiting), France (authorised, recruiting), Spain (ongoing, recruiting).
Therapeutic area(s): Diseases [C] - Neoplasms [C04]
Gender: Female, Male. Age: 18-64 years, 65+ years. Enrolment: 16.
Start date (EU): 2026-02-11. Decision date: 2026-02-03. Results received: No. Last updated: 2026-04-13.
Decision dates by country: NL: 2026-02-03, ES: 2026-02-09, FR: 2026-02-05

Condition(s): Urothelial carcinoma
Product: KEYTRUDA 25 mg/mL concentrate for solution for infusion., MK-3120, ENFORTUMAB VEDOTIN

Primary endpoint: Number of Participants Who Experienced At Least One Adverse Event (AE), Number of Participants with Dose-limiting Toxicities, Number of Participants Who Discontinued Study Treatment Due to an AE, Objective Response Rate (ORR) as Assessed by Investigator
Endpoint(s): Duration of Response (DOR) as Assessed by Investigator, Serum Maximum Concentration (Cmax) of MK-3120 Antibody-Drug Conjugate (ADC), Serum Trough Concentration (Ctrough) of MK-3120 ADC, Serum Cmax of MK-3120 Total Antibodies (TAb), Serum Ctrough of MK-3120 TAb, Plasma Cmax of MK-3120 Free Payload, Plasma Ctrough of MK-3120 Free Payload, Serum Cmax of Enfortumab Vedotin (EV) ADC, Serum Ctrough of EV ADC, Serum Cmax of EV TAb, Serum Ctrough of EV TAb, Plasma Cmax of EV Free Payload, Plasma Ctrough of EV Free Payload

Source: https://euclinicaltrials.eu/ctis-public/view/2025-522253-19-00